EU clinical trial 2026-526314-90-00: Unprescribing the Pill to Reassess Symptom and Cognitive Recovery in Depression (UNPRESCRIB-D)
Sponsor: Region Hovedstaden (Hospital/Clinic/Other health care facility). Phase: Therapeutic use (Phase IV). Countries: Denmark (authorised, recruitment pending).
Therapeutic area(s): Psychiatry and Psychology [F] - Mental Disorders [F03]
Gender: Female. Age: 18-64 years. Enrolment: 106.
Status: Authorised, recruitment pending. Decision date: 2026-06-29. Results received: No. Last updated: 2026-06-29.

Condition(s): Major Depressive Disorder
Product: SERTRALINE, DULOXETINE, DULOXETINE, PLACEBO, SERTRALINE, Femicept, overtrukne tabletter

Primary endpoint: The mean Hamilton Depressive Rating Scale 6-item (HRDS-6) score, The mean total Verbal Affective Memory Task 24 (VAMT-24) recall score calculated as the average score across the immediate (0-24), short- (0-24), and long-term (0-24) recall
Endpoint(s): Antidepressant treatment titration rank as defined in the protocol, Mean HRDS-6 score, The mean total Rey- Auditory Verbal Learning Test (RAVLT) recall score calculated as the average score across the immediate (0-15), short- (0-15), and long-term (0-15) recall, Domain-specific end point 1: Mean striatal 5-HT4R non-displaceable binding potential (BPND) as measured by positron emission tomography, Domain-specific end point 2a: Mean hypothalamic blood flow response to oral glucose as a proxy for brain insulin sensitivity, Domain-specific end point 2b: Mean hypothalamic blood-oxygen-level-dependent response to oral glucose, Domain-specific end point 2c: Mean Homeostatic Model Assessment of Insulin Resistance (HOMA-IR) as a measure for peripheral insulin sensitivity, Domain-specific end point 3: Mean cortisol awakening response, Domain-specific end point 4a: Mean extra-neurite mean diffusivity as a proxy for brain inflammation, Domain-specific end point 4b: Mean hcCRP as a measure of peripheral inflammation, Domain-specific end point 4c: kynurenic acid/quinolinic acid ratio (neuroprotective index), Domain-specific end point 5: Mean hippocampal activation as measured by functional magnetic resonance imaging (fMRI) during a memory encoding paradigm, Domain-specific end point 6a: Mean Element of Desire score, Domain-specific end point 6b: Mean ventral striatal activation as measured by fMRI during a monetary reward paradigm, Domain-specific end point 7: Mean General Anxiety Disorder-7 score, Domain-specific end point 8: Mean resting state functional connectivity as measured with resting state fMRI, Domain-specific end point 9: Mean hippocampal gray matter volume as measured with magnetic resonance imaging (MRI), Domain-specific end point 10a: Gut microbiome composition, Domain-specific end point 10b: Mean gut microbiome-derived metabolites, Domain-specific end point 11: Mean Pittsburgh Sleep Quality Index score, Domain-specific end point 12a: Mean Major Depression Inventory (MDI) score, Domain-specific end point 12b: Mean HRDS-6 score, Domain-specific end point 12c: Treatment titration rank (defined in the protocol), Domain-specific end point 12d: Time to remission, Domain-specific end point 12e: Time to hospitalization, suicide, suicide attempt, or treatment switches/add-on

Source: https://euclinicaltrials.eu/ctis-public/view/2026-526314-90-00